EU clinical trial 2025-520461-41-00: An open-label Phase 2a study to evaluate the safety and efficacy of AlloNK®, an allogeneic cord blood-derived NK cell therapy, in combination with rituximab in relapsing forms of B-cell dependent rheumatologic diseases
Protocol code: AB-101-05
Sponsor: Artiva Biotherapeutics Inc. (Laboratory/Research/Testing facility). Phase: Therapeutic exploratory (Phase II). Countries: Portugal (ongoing, recruiting), Bulgaria (ongoing, recruiting), Germany (ongoing, recruiting), Spain (ongoing, recruiting), Romania (ongoing, recruiting), Italy (authorised, recruiting), France (ongoing, recruiting), Poland (ongoing, recruiting).
Therapeutic area(s): Diseases [C] - Immune System Diseases [C20]
Gender: Female, Male. Age: 18-64 years, 65+ years. Enrolment: 17.
Start date (EU): 2025-10-22. Decision date: 2025-08-19. Results received: No. Last updated: 2026-07-16.
Decision dates by country: RO: 2025-09-18, BG: 2025-08-25, PL: 2025-08-22, PT: 2025-08-21, DE: 2025-08-20, FR: 2025-08-20, ES: 2025-08-20, IT: 2025-08-19

Condition(s): Rheumatoid Arthritis (RA), Sjögren’s Disease (SjD), Systemic Sclerosis (SSc), Idiopathic Inflammatory Myopathies (IIMs)
Product: RITUXIMAB, AB-101, CYCLOPHOSPHAMIDE, FLUDARABINE

Primary endpoint: Dose- limiting toxicities will be assessed at each dose level in a 3+3 design to determine the MTD and/or MAD. Disease specific primary efficacy endpoints will be measured at Week 52. 1. Idiopathic Inflammatory Myopathies: TIS ≥ 60 2. Systemic Sclerosis: rCRISS ≥ 50, 3. Rheumatoid Arthritis: Disease Activity Score 28 (DAS28 - ESR) < 2.6 4. Sjögren’s Disease: Improvement from baseline in Clinical EULAR Sjögren's Syndrome Disease Activity Index (ClinESSDAI) of ≥ 4
Endpoint(s): 1. Safety will be assessed according to the SoA by monitoring AEs, co-meds, physical exams, ECGs, vital signs, and lab test findings. AEs will be coded using MedDRA and graded for severity by the Investigator using the Common Terminology Criteria for Adverse Events Version 5.0, with the exception of the following adverse events:, 2. CRS events will be assessed by ASTCT grading; ICANS events will be assessed by ASTCT grading; GvHD diagnosis and grading of GvHD should follow the MAGIC criteria, 3. The following biomarkers will be measured at baseline and at the timepoints specified in the SoA (Table 1): • Autoantibodies for RA: Rheumatoid factor (RF), anti-citrullinated protein antibodies (ACPA, e.g. anti-cyclic citrullinated peptide [CCP]). • Autoantibodies for IMM: anti-synthetase autoantibodies (e.g. anti-Jo-1, PL-7, PL-12, EJ, OJ, KS), anti-SRP, anti-Mi-2, anti-p140), 4. • Autoantibodies for SSc: e.g. anti-CENP-A/B/C, anti-topo-1, anti-RNAPI/III, anti-Scl70, anti-Jo1, anti-SSA. • Autoantibodies for SjD: Disease associated, e.g., anti-Ro (anti-SS-A) and anti-La (anti-SS-B), 6. Secondary Humoral Immunogenicity Endpoint Humoral immunogenicity will be determined by measuring anti-HLA antibodies specific to AlloNK® in subjects’ serum as specified in the SoA (Table 1). Exploratory objectives and associated endpoints are provided in the protocol.

Source: https://euclinicaltrials.eu/ctis-public/view/2025-520461-41-00